EU clinical trial 2024-512864-71-00: ADP-A2M4CD8 in advanced cancers
Protocol code: ADP-0055-001
Sponsor: USWM Ct LLC (Pharmaceutical company). Phase: Human Pharmacology (Phase I)- Other. Countries: Spain (ongoing, recruitment ended).
Therapeutic area(s): Diseases [C] - Neoplasms [C04]
Gender: Female, Male. Age: 18-64 years, 65+ years. Enrolment: 32.
Status: Ongoing, recruitment ended. Start date (EU): 2020-05-27. Decision date: 2024-05-23. Results received: No. Last updated: 2026-06-12.

Condition(s): Urothelial cancer; Esophageal cancer; Gastric cancer; Non-small cell lung carcinoma (NSCLC); Head and neck cancer carcinoma; Ovarian carcinoma; Melanoma; Endometrial carcinoma

Source: https://euclinicaltrials.eu/ctis-public/view/2024-512864-71-00